EU clinical trial 2024-514490-22-01: Pharmacological treatment of compulsive sexual behaviour disorder
Protocol code: CSBD-TR
Sponsor: Centrum Medycznego Ksztalcenia Podyplomowego (Educational Institution). Phase: Therapeutic confirmatory (Phase III). Countries: Poland (ongoing, recruiting).
Therapeutic area(s): Psychiatry and Psychology [F] - Mental Disorders [F03]; Psychiatry and Psychology [F] - Psychological Phenomena [F02]; Psychiatry and Psychology [F] - Behavior and Behavior Mechanisms [F01]
Gender: Male. Age: 18-64 years. Enrolment: 410.
Status: Ongoing, recruiting. Start date (EU): 2025-06-12. Decision date: 2025-02-24. Results received: No. Last updated: 2026-05-26.

Condition(s): Compulsive Sexual Behaviour Disorder
Product: Capsules containing tablets with microcrystalline cellulose 102 245 mg and magnesium stearate 5 mg., NALTREXONE HYDROCHLORIDE, ESCITALOPRAM OXALATE

Primary endpoint: Scores obtained on the CSBD-19 scale, Scores obtained on the BPS scale, Frequency of compulsive sexual behavior measured by patient diary data., The severity of the perceived “desire” for compulsive sexual behavior
Endpoint(s): Scores obtained on the CSBD-DI scale., Scores obtained on the HADS scale., Scores obtained on the DERS-SF scale., Scores obtained on the IIEF-15 scale., Scores obtained on the BIS scale., Responsiveness to erotic stimulus cues measured by behavioral performance (reaction time and correctness of performance) in the Incentive Delay Task, Reactivity to cues of erotic stimuli measured by neuronal indices (amplitude of evoked potentials in EEG) in the Incentive Delay Task, Scores obtained on the CSBD-19 scale, Scores obtained on the BPS scale, Frequency of compulsive sexual behavior measured by patient diary data., The severity of the perceived “desire” for compulsive sexual behavior.

Source: https://euclinicaltrials.eu/ctis-public/view/2024-514490-22-01